EU clinical trial 2024-516115-24-00: BEACON 2: A Multi-Arm, Multi-Stage Platform Trial For Relapsed Neuroblastoma
Protocol code: RG_22-136
Sponsor: The University Of Birmingham (Educational Institution). Phase: Phase I and Phase II (Integrated)- Other. Countries: France (authorised, recruitment pending), Austria (authorised, recruitment pending), Germany (authorised, recruitment pending), Belgium (authorised, recruitment pending), Norway (authorised, recruitment pending), Denmark (authorised, recruiting), Sweden (authorised, recruitment pending), Italy (authorised, recruitment pending), Spain (authorised, recruitment pending), Netherlands (authorised, recruitment pending).
Therapeutic area(s): Diseases [C] - Neoplasms [C04]
Gender: Female, Male. Age: 0-17 years, 18-64 years. Enrolment: 102.
Start date (EU): 2026-07-08. Decision date: 2025-07-28. Results received: No. Last updated: 2026-06-01.
Decision dates by country: IT: 2025-07-30, ES: 2025-07-29, NL: 2025-07-30, AT: 2025-08-04, BE: 2025-07-28, DK: 2025-07-28, FR: 2025-07-29, DE: 2025-07-29, SE: 2025-08-01, NO: 2025-07-29

Condition(s): High risk relapsed neuroblastoma (relapsed or progressed after being defined as High Risk at any time following diagnosis or progressed/relapsed as high-risk neuroblastoma), which is histologically proven as per International Neuroblastoma Staging System (INSS) definition.
Product: TEMOZOLOMIDE, TOPOTECAN, TEMOZOLOMIDE, TEMOZOLOMIDE, IRINOTECAN, TEMOZOLOMIDE, TEMOZOLOMIDE, Kimozo 40 mg/ml, suspension buvable, TEMOZOLOMIDE, TOPOTECAN, BEVACIZUMAB, Qarziba 4.5 mg/mL concentrate for solution for infusion

Primary endpoint: Progression-Free Survival time (as per INRC 2017) – for Tier 1 (randomised comparison), Definition of a safe and tolerable combination regimen – for Tier 2 (dose confirmation cohorts)
Endpoint(s): Tier 1 Overarching Secondary Endpoint: Best objective response (complete or partial response) as per INRC 2017 during trial treatment (12 cycles) as per investigator assessment, Tier 1 Overarching Secondary Endpoint: Clinical benefit (complete, partial, minor response or stable disease) as per the INRC 2017 as per investigator assessment., Tier 1 Overarching Secondary Endpoint: Duration of response (for responders (CR or PR) only), Tier 1 Overarching Secondary Endpoint: Overall Survival time, Tier 1 Overarching Secondary Endpoint: Quality of life measured by Peds-QL questionnaires, Tier 1 Overarching Secondary Endpoint: Incidence and Severity of toxicities (AEs & SAEs), Tier 1 BICR Specific Secondary Endpoints (Arms A and B): Confirmed Objective Response (complete or partial response) as per INRC 2017 at any time during 6 and 12 cycles of treatment, responses confirmed by BICR. (N.B. the cycle 6 time point forms the primary outcome for the purposes of BLA submission), Tier 1 BICR Specific Secondary Endpoints (Arms A and B): Duration of Confirmed Objective Response (for BICR confirmed responders (CR or PR)), Tier 1 BICR Specific Secondary Endpoints (Arms A and B): Confirmed Objective Response (complete or partial response) as per INRC 2017 at the end of 6 cycles of treatment, responses confirmed by BICR, Tier 1 BICR Specific Secondary Endpoints (Arms A and B): Extended Confirmed Objective Response (complete, partial or minor response) as per INRC 2017 at any time during 6 cycles and 12 cycles of treatment, responses confirmed by BICR, Tier 1 BICR Specific Secondary Endpoints (Arms A and B): Duration of Extended Confirmed Response (for BICR confirmed responders (CR, PR, MR)), Tier 2 Specific Secondary Endpoint: Best Objective Response (complete or partial response) as per INRC 2017 during treatment (12 cycles), Tier 2 Specific Secondary Endpoint: Clinical benefit (complete, partial and minor response and stable disease) as per the INRC 2017, Tier 2 Specific Secondary Endpoint: Quality of life measured by Peds-QL questionnaires, Tier 2 Specific Secondary Endpoint: Incidence and Severity of toxicity (AEs and SAEs), Tier 1 – Arm A Specific Secondary Endpoints (Laboratory): To measure dinutuximab beta serum concentration immediately pre-Db infusions and immediately post- Db infusions, Tier 1 – Arm A Specific Secondary Endpoints (Laboratory): To measure ADA to dinutuximab beta immediately pre-Db infusion, Tier 1 – Arm A Specific Secondary Endpoints (Laboratory): To measure CDC immediately pre-Db and immediately post-Db infusion

Source: https://euclinicaltrials.eu/ctis-public/view/2024-516115-24-00